EU clinical trial 2023-510381-28-01: A parallel-group treatment, Phase 4, prospective multicenter double-blind randomized 2-arm placebo-controlled study to investigate the effect of single dose topical administration of tranexamic acid vs placebo onto surgical wound surfaces on postoperative re-bleeding, wound complications, seroma and thromboembolic events in male and female patients above 18 years of age undergoing plastic surgery.
Protocol code: 270777
Sponsor: St. Olavs Hospital HF (Hospital/Clinic/Other health care facility). Phase: Therapeutic use (Phase IV). Countries: Norway (ongoing, recruiting), Finland (ongoing, recruiting), Denmark (ongoing, recruiting).
Therapeutic area(s): Analytical, Diagnostic and Therapeutic Techniques and Equipment [E] - Therapeutics [E02]
Gender: Female, Male. Age: 18-64 years, 65+ years. Enrolment: 3500.
Status: Ongoing, recruiting. Start date (EU): 2024-09-18. Decision date: 2024-06-19. Results received: No. Last updated: 2026-03-20.
Decision dates by country: FI: 2025-03-19, DK: 2025-09-14, NO: 2024-06-19

Condition(s): Patients undergoing plastic surgical procedures with wounds that would normally receive application of TXA to reduce bleeding after surgery.
Product: CHLORURE DE SODIUM 0,9 % LAVOISIER, solution pour perfusion, Cyklokapron 100 mg/ml injeksjons-/infusjonsvæske, oppløsning

Primary endpoint: Given one or several of the following occurrences, re-bleeding will be defined as “yes”: Re-operation, surgical exploration or evacuation, aspiration, blood transfusion or external extra compression due to hematoma within the first postoperative 10 days
Endpoint(s): Postoperative wound infection: Infection within the first 30 days requiring any of the following: Extra outpatient follow-up, re-operation, or revision or antibiotic treatment., Postoperative wound rupture: Wound rupture within the first 30 days requiring any of the following: Extra outpatient follow-up, re-operation, or revision., Thromboembolic events defined as thrombophlebitis, deep venous thrombosis, pulmonary embolus, cerebral or coronary infarctions until 30 days postoperatively., Seroma defined as the need for aspiration of fluids, or spontaneous evacuation of voluminous fluids, between 10 and 30 days postoperatively., Other possible adverse effects causing contact with the health service until 30 days postoperatively.

Source: https://euclinicaltrials.eu/ctis-public/view/2023-510381-28-01